EU clinical trial 2024-511192-15-00: Optimizing reversal of HIV latency with combination therapy (pyrimethamine, lenalidomide, panobinostat)
Protocol code: 1.6
Sponsor: Erasmus Universitair Medisch Centrum Rotterdam (Erasmus MC) (Hospital/Clinic/Other health care facility). Phase: Therapeutic exploratory (Phase II). Countries: Netherlands (ended).
Therapeutic area(s): Diseases [C] - Virus Diseases [C02]
Gender: Female, Male. Age: 18-64 years, 65+ years. Enrolment: 49.
Status: Ended. Start date (EU): 2024-07-07. End date (EU): 2026-04-30. Decision date: 2024-05-07. Results received: No. Last updated: 2025-03-07.

Condition(s): HIV-1
Product: PYRIMETHAMINE, LENALIDOMIDE, PANOBINOSTAT

Primary endpoint: The fold change in cell-associated HIV-RNA at time points 6 and 24 hours as compared to baseline (time point 0 hour), The number and severity of clinical and biochemical adverse events considered by the investigator to be related to any of the investigational drugs.
Endpoint(s): 1. The fold change in cell-associated HIV-RNA on LRA monotherapy components compared to combination LRA treatments., 2. The change in the HIV reservoir size and genetic composition from baseline to the end of the study., 3. The level of immune activation, and phenotype and functionality of the cellular immunity as compared from baseline to end of treatment., 4. The plasma concentrations of the investigational drugs during treatment., 5. Correlations of ex vivo and in-vivo cell associated HIV-RNA responses to the investigational drugs., 6. The association between clinical variables and the primary endpoints., 7. The number and frequency of measurable (above limit of detection or above limit of quantitation) plasma HIV-RNA during treatment., 8. Number of upward and downward counterfactuals

Source: https://euclinicaltrials.eu/ctis-public/view/2024-511192-15-00